EU clinical trial 2022-501465-40-00: Randomized Phase 2 Study of DKN-01 Plus FOLFIRI/FOLFOX and Bevacizumab Versus FOLFIRI/FOLFOX and Bevacizumab as Second-line Treatment of Advanced Colorectal Cancer (DeFianCe)
Protocol code: DEK-DKK1-P207
Sponsor: Leap Therapeutics Inc. (Pharmaceutical company). Phase: Therapeutic exploratory (Phase II). Countries: Germany (ended).
Therapeutic area(s): Diseases [C] - Neoplasms [C04]
Gender: Female, Male. Age: 18-64 years, 65+ years. Enrolment: 25.
Status: Ended. Start date (EU): 2023-12-22. End date (EU): 2025-07-02. End date: 2025-07-03. Decision date: 2023-02-10. Results received: Yes. Last updated: 2025-06-12.

Condition(s): Colorectal Cancer
Product: CALCIUM FOLINATE, Fluorouracil Hikma 50 mg/ml Injektionslösung, IRINOTECAN HYDROCHLORIDE, DKN-01, Oxaliplatin 5mg/ml concentrate for solution for infusion, Aybintio 25 mg/ml concentrate for solution for infusion.

Primary endpoint: Progression free survival (PFS), as determined by the Investigator per RECIST v1.1 of DKN-01 plus standard care (SOC) versus SOC in all patients with advanced colorectal cancer and in patients with left-sided advanced colorectal cancer.
Endpoint(s): Objective response rate (ORR), as determined by the Investigator per RECIST v1.1 of DKN-01 plus SOC versus SOC, Duration of response (DoR), as determined by the Investigator per RECIST v1.1 of DKN-01 plus SOC versus SOC, Overall survival (OS) with DKN-01 plus SOC versus SOC., Incidence of ≥Grade 3 related treatment-related adverse events (TRAEs)

Source: https://euclinicaltrials.eu/ctis-public/view/2022-501465-40-00